EU clinical trial 2024-512002-26-00: Bladder Sparing : Phase II study of maintenance anti-PD-L1 treatment with atezolizumab after chemo-radiotherapy for muscle-infiltrating bladder cancer patients not eligible for radical cystectomy
Sponsor: Unicancer (Hospital/Clinic/Other health care facility). Phase: Therapeutic exploratory (Phase II). Countries: France (ongoing, recruiting).
Therapeutic area(s): Diseases [C] - Neoplasms [C04]
Gender: Female, Male. Age: 18-64 years, 65+ years. Enrolment: 77.
Status: Ongoing, recruiting. Start date (EU): 2019-02-19. Decision date: 2024-05-24. Results received: No. Last updated: 2024-05-24.

Condition(s): Muscle-invasive bladder cancer
Product: Tecentriq 1 200 mg concentrate for solution for infusion

Primary endpoint: Disease-free survival (DFS) will be assessed at 2 years. DFS is defined as the delay between date of inclusion, and tumour progression (local, regional, or distant) or death of any cause, whichever occurs first.
Endpoint(s): Local control rate will be evaluated by cystoscopy at 2 and 5 years. The presence of nonmuscle- invasive or muscle-invasive bladder cancers will be considered as a local failure. To be defined as locally controlled, the bladder must be completely free of tumour. Duration of local control will be calculated from the date of inclusion till the date of positive cystoscopy. In case of regional or distant relapse occurring before local relapse, data will be censored at the time of relapse., Disease-free survival (DFS) will be assessed at 5 years. DFS is defined as the delay between date of inclusion, and tumour progression (local, regional, or distant) or death of any cause, whichever occurs first., Overall Survival (OS) will be assessed at 2 and 5 years. OS is defined as the delay between the date of inclusion and the date of death, of any cause., The tolerance and safety will be evaluated by toxicity: acute (<6 months after the start of treatment) and late (≥6 months after the start of treatment), assessed using the NCI CTCAE v5.0 (see Appendix 2). The tolerance will be evaluated up until 5 years., Quality of life

Source: https://euclinicaltrials.eu/ctis-public/view/2024-512002-26-00